EU clinical trial 2024-514820-18-00: Phase II trial of vaccination with lysate-loaded, mature dendritic cells integrated into standard radiochemotherapy in newly diagnosed glioblastoma
Protocol code: GlioVax
Sponsor: Heinrich-Heine-Universitaet Duesseldorf (Educational Institution). Phase: Therapeutic exploratory (Phase II). Countries: Germany (ongoing, recruitment ended).
Therapeutic area(s): Diseases [C] - Neoplasms [C04]
Gender: Female, Male. Age: 18-64 years, 65+ years. Enrolment: 136.
Status: Ongoing, recruitment ended. Start date (EU): 2018-03-07. Decision date: 2024-08-26. Results received: No. Last updated: 2025-10-10.

Condition(s): newly diagnosed glioblastoma
Product: Autologous, tumor lysate-loaded, mature dendritic cells vaccine

Primary endpoint: The primary efficacy endpoint is OS measured from the day of surgery until death.
Endpoint(s): PFS as measured from the day of surgery until diagnosis of tumor progression by MRI according to modified RANO criteria (the exact time of progression may be defined retrospectively, when pseudoprogression and pseudoresponses can be excluded definitively) or death due to any cause., OS and PFS rates at 6, 12 and 24 months after the day of surgery., Safety based on the frequency and severity of adverse events with toxicity graded according to the NCI CTCAE version 4.03., Overall and neurological performance as determined by the KPS and the MMSE-2., Quality of life as determined by the EORTC questionnaires QLQ-C30 version 3.0 and QLQ-BN20 as well as the DT and HADS for psycho-oncological stress assessment.

Source: https://euclinicaltrials.eu/ctis-public/view/2024-514820-18-00